EU clinical trial 2023-509795-42-00: TicAgreLor versus placebo to prevent cerebral ISCHemia in anEuRysmal low grade SAH A double blinded randomised controlled study TALISCHER - SAH
Protocol code: RC31/23-0369
Sponsor: Centre Hospitalier Universitaire De Toulouse (Hospital/Clinic/Other health care facility). Phase: Therapeutic confirmatory (Phase III). Countries: France (authorised, recruitment pending).
Therapeutic area(s): Diseases [C] - Nervous System Diseases [C10]
Gender: Female, Male. Age: 18-64 years, 65+ years. Enrolment: 274.
Status: Authorised, recruitment pending. Decision date: 2026-06-04. Results received: No. Last updated: 2026-06-04.

Condition(s): Aneurysmal subarachnoid hemorrhage
Product: Placebo du brilique, Brilique 90 mg film-coated tablets

Primary endpoint: -Symptomatic and asymptomatic peri-procedural thromboembolic events (0-24hrs): • Angiographic : any event with clotting near the neck of the aneurysm or in distal branches and parent vessel occlusion in any vascular territory during procedure, and/or • Clinical : worsening neurological deficit ≥2pts on NIHSS from baseline and/or • Imaging : acute infarcts on 24h MRI. Acute qualifying infarcts for evaluation criteria will be defined as ≥ 5 hyperintense DWI lesions or a lesion larger than 10 mm
Endpoint(s): Related to peri procedural asymptomatic and symptomatic TEE within 24 h of aneurysmal treatment : Occurrence of at least: • One peri procedural angiographic TEE • One peri procedural clinical TEE • A severe symptomatic ischemic lesion defined by worsening >4 pts on NIHSS from baseline • One peri procedural imaging TEE • One periprocedural TEE (angiographic and/or clinical and/or imaging), Related to neurological deterioration and asymptomatic lesions on MRI due to DCI Occurrence of at least • A neurological deterioration due to DCI • A severe neurologic deterioration due to DCI • Asymptomatic MRI lesions • One ischemic event (clinical/ MRI) related to DCI, Combined incidence of all ischemic events: sum of both type of ischemic events (related to TEE and/or DCI) /patient at day 15, Rate of rescue therapy during angiography and/ or DCI, Aneurysm occlusion at procedure completion, 24 h, and 3months MRI-MRA (Raymond Roy classification), Clinical outcome at 3 months: • Rate of good Functional outcome: mRS<3 and GOSE> 5 • Quality of life assessed by EQ- 5D • Rate of cognitive deterioration defined by MoCA score ≤ 25 • Rate of deaths, Occurrence of adverse events: • Aneurysmal rupture • Intracranial bleedings • Other major bleedings : Fatal bleeding, and/or symptomatic bleeding in a critical area or organ … • Minor bleedings • Non hemorrhagic adverse events of ticagrelor in particular rate of patients with dyspnea, bradyarythmia, increase uric acid and creatinemia measured at baseline (randomization) at day 7 and 15.

Source: https://euclinicaltrials.eu/ctis-public/view/2023-509795-42-00